EU clinical trial 2023-504141-31-00: Discontinuation of CDK4/6 inhibitors in patients with metastatic HR positive, HER2 negative breast cancer with durable disease control: A randomized low-intervention phase II trial of the AIO working groups breast cancer and quality of life
Protocol code: DISCUSS
Sponsor: Institut fuer Klinische Krebsforschung IKF GmbH (Pharmaceutical company). Phase: Therapeutic exploratory (Phase II). Countries: Germany (ongoing, recruiting).
Therapeutic area(s): Diseases [C] - Neoplasms [C04]
Gender: Female. Age: 18-64 years, 65+ years. Enrolment: 120.
Status: Ongoing, recruiting. Start date (EU): 2024-01-17. Decision date: 2023-11-10. Results received: No. Last updated: 2026-05-28.

Condition(s): Metastatic HR positive, HER2 negative breast cancer
Product: ABEMACICLIB, EXEMESTANE, LETROZOLE, PALBOCICLIB, RIBOCICLIB, FULVESTRANT, ANASTROZOLE

Primary endpoint: Progression-free survival rate 12 months after randomization (PFS@12_stopping), defined as proportion of patients alive and without progression according to radiologic imaging assessment

Source: https://euclinicaltrials.eu/ctis-public/view/2023-504141-31-00